EU clinical trial 2024-510904-36-00: Leflunomide and Hydroxychloroquine combination therapy for primary Sjögren’s Syndrome; RepurpSS-II study
Sponsor: Universitair Medisch Centrum Utrecht (Hospital/Clinic/Other health care facility). Phase: Therapeutic exploratory (Phase II). Countries: Netherlands (ended).
Therapeutic area(s): Diseases [C] - Immune System Diseases [C20]
Gender: Female, Male. Age: 18-64 years, 65+ years. Enrolment: 52.
Status: Ended. Start date (EU): 2021-10-12. End date (EU): 2025-06-03. Decision date: 2024-06-11. Results received: Yes. Last updated: 2024-06-11.

Condition(s): primary Sjögren's Syndrome
Product: Leflunomide CF 20 mg, filmomhulde tabletten, Hydorxychloroquine 200mg/Placebo, Hydroxychloroquinesulfaat 200 mg Focus, filmomhulde tabletten, Hydroxychloroquinesulfaat CF 200 mg, filmomhulde tabletten, Leflunomide Mylan 10 mg, filmomhulde tabletten, Leflunomide 20mg/Placebo, Leflunomide Mylan 20 mg, filmomhulde tabletten, Plaquenil 200 mg, filmomhulde tabletten

Primary endpoint: The change in ESSDAI upon treatment with LEF/HCQ in pSS patients from baseline to 24 weeks, as compared to treatment with placebo-LEF and placebo-HCQ.
Endpoint(s): The change upon treatment with LEF/HCQ in pSS patients from baseline upto 24 weeks, as compared to placebo, in the change in dryness as measured by unstimulated whole unstimulated and stimulated saliva output in pSS patients., The change upon treatment with LEF/HCQ in pSS patients from baseline upto 24 weeks, as compared to placebo, in EULAR Sjögren’s Syndrome Patient Reported Index or ESSPRI (disease activity from patient’s perspective), The change upon treatment with LEF/HCQ in pSS patients from baseline upto 24 weeks, as compared to placebo, in Lachrymal flow measured by Shirmer’s test, Ocular Staining Score and Tear breakup time., The change upon treatment with LEF/HCQ in pSS patients from baseline upto 24 weeks, as compared to placebo, in the change in tender joint count and swollen joint count (68/66).

Source: https://euclinicaltrials.eu/ctis-public/view/2024-510904-36-00